EU clinical trial 2024-512845-18-00: Evaluation of Safety, Tolerability and Efficacy of Crofelemer following Multiple Ascending Doses of Crofelemer Powder for Oral Solution in Pediatric Participants with Microvillus Inclusion Disease (MVID)
Protocol code: NP303-104
Sponsor: Napo Pharmaceuticals Inc. (Pharmaceutical company). Phase: Phase II and Phase III (Integrated). Countries: Italy (ongoing, recruitment ended).
Therapeutic area(s): Diseases [C] - Digestive System Diseases [C06]; Diseases [C] - Congenital, Hereditary, and Neonatal Diseases and Abnormalities [C16]; Diseases [C] - Nutritional and Metabolic Diseases [C18]
Gender: Female, Male. Age: 0-17 years. Enrolment: 4.
Status: Ongoing, recruitment ended. Start date (EU): 2025-06-03. Decision date: 2024-08-22. Results received: No. Last updated: 2026-07-29.

Condition(s): Microvillous Inclusion Disease (MVID)
Product: Crofelemer Placebo Powder for Oral Solution

Primary endpoint: Assessment of AEs, SAEs, laboratory evaluations, physical exam (including height, weight, BMI, and assessment of hydration status), and urine output
Endpoint(s): Assessment of change from baseline, compared to placebo, within each dose level and through the end of all study treatment periods (for the randomized double-blind placebo-controlled phase and when applicable for the extension phase) in the following endpoints:, • Average weekly PS volume requirements on a per kg body weight basis (mL/kg), • Average loose/watery stool output volume during 24-hour stool collections, • Average weekly TPN (including lipids) volume requirements, • Average weekly supplemental IV fluid volume requirements, • Average weekly supplemental electrolytes (Na+, K+, Cl-) in PS and, separately, in TPN and IV fluids, • Average weekly acetate or lactate supplementation, • Reduction from baseline in PS and/or TPN requirements, • Stool electrolytes changes (Na+, K+, Cl-) at the end of each treatment period in Dose Level 3

Source: https://euclinicaltrials.eu/ctis-public/view/2024-512845-18-00